EU clinical trial 2024-514137-38-00: A Phase 2, randomized, open-label, controlled study to evaluate the efficacy and safety of rapcabtagene autoleucelversus comparator in participants with severe refractory idiopathic inflammatory myopathies
Protocol code: CYTB323L12201
Sponsor: Novartis Pharma AG (Pharmaceutical company). Phase: Therapeutic exploratory (Phase II). Countries: Spain (temporarily halted), Germany (temporarily halted), France (temporarily halted), Netherlands (temporarily halted), Italy (authorised, recruitment pending), Austria (authorised, recruitment pending), Belgium (authorised, recruitment pending), Czechia (authorised, recruitment pending), Finland (authorised, recruitment pending), Greece (authorised, recruitment pending), Hungary (authorised, recruitment pending), Sweden (authorised, recruitment pending).
Therapeutic area(s): Diseases [C] - Immune System Diseases [C20]
Gender: Female, Male. Age: 18-64 years, 65+ years. Enrolment: 64.
Start date (EU): 2025-02-04. Decision date: 2024-12-20. Results received: No. Last updated: 2026-08-02.
Decision dates by country: DE: 2024-12-20, ES: 2024-12-20, NL: 2025-01-08, FR: 2024-12-20, IT: 2024-12-20, AT: 2026-08-02, BE: 2026-07-31, CZ: 2026-07-30, FI: 2026-07-10, GR: 2026-07-02, HU: 2026-07-06, SE: 2026-07-17

Condition(s): Severe refractory idiopathic inflammatory myopathies (IIM)
Product: MYCOPHENOLATE MOFETIL, MYCOPHENOLIC ACID, CYCLOPHOSPHAMIDE, TACROLIMUS, CYCLOPHOSPHAMIDE, YTB323, TOCILIZUMAB, RITUXIMAB, RITUXIMAB, FLUDARABINE PHOSPHATE

Primary endpoint: Achieving moderate to major improvement in TIS (TIS ≥ 40) at Week 52 (Yes/No)
Endpoint(s): Achieving moderate to major improvement in TIS (≥ 40) at Week 52 (Yes/No), Adjusted annual cumulative GC dose up to Week 52, Change from baseline in percent predicted Forced Vital Capacity (FVC%) at Week 52, Achieving major improvement in TIS (≥ 60) at Week 52 (Yes/No), Change from baseline in Patient-Reported Outcome Measurement Information System (PROMIS)-Fatigue 7a at Week 52, Safety parameters include vital signs, adverse events, laboratory parameters and ECG evaluation

Source: https://euclinicaltrials.eu/ctis-public/view/2024-514137-38-00